EU clinical trial 2024-515256-21-00: Mechanisms of action on rectal motility of intrarectal botulinum toxin injections in patients with fecal incontinence - MECA-TOX
Protocol code: 2021/0384/HP
Sponsor: Centre Hospitalier Universitaire Rouen (Hospital/Clinic/Other health care facility). Phase: Therapeutic confirmatory (Phase III). Countries: France (ongoing, recruiting).
Therapeutic area(s): Diseases [C] - Digestive System Diseases [C06]
Gender: Female, Male. Age: 18-64 years, 65+ years. Enrolment: 21.
Status: Ongoing, recruiting. Start date (EU): 2025-03-21. Decision date: 2024-07-19. Results received: No. Last updated: 2026-02-06.

Condition(s): Fecal incontinence
Product: DULCOLAX 5 mg, comprimé enrobé gastro-résistant, BOTOX 200 UNITÉS ALLERGAN, poudre pour solution injectable, MOVIPREP, poudre pour solution buvable en sachet

Primary endpoint: The primary endpoint was the time to onset of high amplitude propagative contractions (HAPC) after instillation of DULCOLAX® in the sigmoid and rectum, before and 1 month after intra-rectal botulinum toxin injections.
Endpoint(s): The characteristics of the contractions at the level of the rectum and the sigmoid measured before then 1 month after injections of botulinum toxin: number, frequency, amplitude, duration of the HAPC, index of contractility, number and characteristics of the contractions (propagated or retropropagated)., Expulsion or not of the probe (which is an indirect sign of the efficiency of the colorectal motricity) as well as the delay of expulsion of the probe., Severity scores (Cleveland Score, Appendix 2), stool schedule and quality of life score (FIQL Score, Appendix 4) before and 1 month after botulinum toxin injections., Adverse events, which will be collected at each visit, The quality of life score (FIQL Score, Appendix 4) before and 1 month after botulinum toxin injections.

Source: https://euclinicaltrials.eu/ctis-public/view/2024-515256-21-00